EU clinical trial 2023-509088-26-00: Single arm phase II study of ctDNA-guided encorafenib plus cetuximab retreatment in patients with BRAF V600E mutated mCRC. BRICKET study
Sponsor: Fondazione GONO G.I. (Patient organisation/association). Phase: Therapeutic exploratory (Phase II). Countries: Italy (ongoing, recruitment ended).
Therapeutic area(s): Diseases [C] - Digestive System Diseases [C06]; Diseases [C] - Neoplasms [C04]
Gender: Female, Male. Age: 18-64 years, 65+ years. Enrolment: 16.
Status: Ongoing, recruitment ended. Start date (EU): 2024-07-22. Decision date: 2024-06-21. Results received: No. Last updated: 2026-06-03.

Condition(s): Metastatic colorectal cancer
Product: Braftovi 75 mg hard capsules, Erbitux 5 mg/mL solution for infusion

Primary endpoint: Objective Response Rate (ORR) defined as the percentage of patients, relative to the total of enrolled subjects, achieving a complete (CR) or partial (PR) response, according to RECIST 1.1 criteria. The determination of clinical response will be based on investigator-reported measurements. Responses will be evaluated with a chest and abdominal computed tomography (CT) scan every 8 weeks.
Endpoint(s): Progression Free Survival (PFS) is defined as the time interval computed from the date of study enrollment to the date of objective progression according to the RECIST criteria (version 1.1) or death, whatever comes first., Overall survival (OS) is defined as the time from the date of study enrollment to the date of death due to any cause. For patients still alive at the time of analysis, the OS time will be censored on the last date the patients were known to be alive., Overall Toxicity Rate is defined as the percentage of patients, relative to the total of enrolled subjects, experiencing any adverse event, according to National Cancer Institute Common Toxicity Criteria (version 5.0), G3/4 Toxicity Rate is defined as the percentage of patients, relative to the total of enrolled subjects, experiencing a specific adverse event of grade 3/4, according to National Cancer Institute Common Toxicity Criteria (version 5.0), Early Objective Response Rate (EORR) is defined as the percentage of patients, relative to the total of the enrolled subjects, achieving a ≥20% decrease in the sum of diameters of RECIST target lesions at week 8 compared to baseline, Depth of Response (DpR) is defined as the relative change in the sum of longest diameters of RECIST target lesions at the nadir, in the absence of new lesions or progression of non-target lesions, when compared with baseline, Clinical outcomes of the screening failure population include collection of therapeutic choices after ctDNA screening; ORRfailure; PFSfailure of the first line after ctDNA screening; OSfailure. For patients still alive at the time of analysis, the OS time will be censored on the last date the patients were known to be alive., Quality of Life (QoL) is assessed using the EORTC QLQ-C30 and the EORTC QLQ-CR29 questionnaires, will be evaluated from patients who have completed at least one questionnaire item at baseline and during the study period through descriptive summary statistics., Time To Deterioration in Quality of Life (TTD) is defined as the time from baseline to the first onset of a 10-point or greater decrease from study enrollment for functional scales or a 10- point or greater increase for symptom scales or death.

Source: https://euclinicaltrials.eu/ctis-public/view/2023-509088-26-00